EU clinical trial 2022-502284-38-00: Sclerotherapy of hydro and spermatoceles with 2ml Aetoxysclerol 30mg/ml vs. a combination of 2ml Aetoxysclerol 30mg/ml and 25ml of ethanol 99,5% with or without local anesthesia
Sponsor: Region Jamtland Harjedalen (Hospital/Clinic/Other health care facility). Phase: Therapeutic confirmatory (Phase III). Countries: Sweden (ongoing, recruiting).
Therapeutic area(s): Diseases [C] - Male Urogenital Diseases [C12]
Gender: Male. Age: 18-64 years, 65+ years. Enrolment: 300.
Status: Ongoing, recruiting. Start date (EU): 2025-05-05. Decision date: 2024-11-06. Results received: No. Last updated: 2025-04-29.

Condition(s): Spermatocele, Hydrocele
Product: Ropivacain Sintetica 7,5 mg/ml Injektionslösung, Bupivacaine Baxter 5 mg/ml injektionsvätska, lösning, Aethoxysklerol 30 mg/ml injektionsvätska, lösning, Mepivacaine Accord 10 mg/ml injektionsvätska, lösning, Lidocaine Accord 10 mg/ml injektionsvätska, lösning, ETHANOL, ANHYDROUS

Primary endpoint: Symptoms from the treated side 3 months from treatment, Pain according to numeric rating scale (0-10) during treatement, Anti-coaculant therapy not suitable to suspend before treatment, Allergy to ethanol, Aethoxysclerol or ant local anaestethics used in the study, Mental disability, reluctance of the patient or language barriers making the purpose of participating in the study difficult to grasp, Current or just finished participation in another clinical pharmacological study, Prior participation in the study at hand, Treatment with immuno-stimulating drugs, Hydro or spermatocele not able to be evacuated percutaneously
Endpoint(s): Complications 30 days from treatement, Retreatement on the treated side, Symptoms from the treated side 24 months from treatment, Pain according to numeric rating scale (0-10) 1 day after treatment

Source: https://euclinicaltrials.eu/ctis-public/view/2022-502284-38-00